EU clinical trial 2022-503167-15-00: The effect of fremanezumab on pain in patients with Complex Regional Pain Syndrome: a randomized, double-blind, proof of concept, placebo-controlled trial
Sponsor: Aarhus University Hospital (Hospital/Clinic/Other health care facility). Phase: Therapeutic exploratory (Phase II). Countries: Denmark (ongoing, recruiting).
Therapeutic area(s): Diseases [C] - Nervous System Diseases [C10]
Gender: Female, Male. Age: 18-64 years, 65+ years. Enrolment: 60.
Status: Ongoing, recruiting. Start date (EU): 2023-12-11. Decision date: 2023-06-08. Results received: No. Last updated: 2024-12-05.

Condition(s): Complex Regional Pain Syndrome
Product: AJOVY 225 mg solution for injection in pre-filled syringe

Primary endpoint: Difference between groups (placebo vs. active treatment) in the change in self-reported daily ratings of mean average daily pain intensity (ADP) in the affected limb from the baseline week to the last week of treatment, as experienced during the past 24 hours, rated on a 0–10-point numeric rating scale (NRS; 0 = no pain, 10 = worst possible pain).
Endpoint(s): Difference in Pain relief on a 6-point scale: complete, good, moderate, mild, none, worse., Difference in the change in mean CRPS severity score (CSS) from end of baseline to end of week 4 and 8., Differences in the area and intensity of mechanical allodynia, assessed by brushing a soft brush (Somedic) twice with a speed of 1-2 cm/s, The relationship between the primary outcome measure and the duration of CRPS (measured in months).

Source: https://euclinicaltrials.eu/ctis-public/view/2022-503167-15-00